EU clinical trial 2024-514865-20-00: PRIDE: A phase IIa, open-label, multicenter study of radiochemotherapy with isotoxic dose escalation and protective VEGF inhibition using bevacizumab in the treatment of patients with first diagnosis of IDH wild-type, MGMT unmethylated glioblastoma
Protocol code: PRIDE
Sponsor: Universitaetsklinikum Tuebingen AöR (Hospital/Clinic/Other health care facility). Phase: Therapeutic exploratory (Phase II). Countries: Germany (ongoing, recruiting).
Therapeutic area(s): Diseases [C] - Neoplasms [C04]
Gender: Female, Male. Age: 18-64 years, 65+ years. Enrolment: 146.
Status: Ongoing, recruiting. Start date (EU): 2024-04-10. Decision date: 2024-07-10. Results received: No. Last updated: 2025-12-09.

Condition(s): Glioblastoma
Product: Aybintio 25 mg/ml concentrate for solution for infusion.

Primary endpoint: Overall survival
Endpoint(s): Safety and tolerability of isotoxic dose escalation and bevacizumab, Progression-free survival after 6 months (PFS-6), Progression-free survival (PFS), Quality of life as determined by EORTC QLQ-C30 and the EORTC brain module QLQ-BN 20, Cognitive function as determined by MMSE and MOCA, Exploratory objective: validation of 4-miRNA signature-based risk subgroups in FFPE material and plasma samples

Source: https://euclinicaltrials.eu/ctis-public/view/2024-514865-20-00